EU clinical trial 2026-526674-17-00: A clinical trial of MK-3868 in healthy participants (MK-3868-001)
Protocol code: MK-3868-001
Sponsor: Merck Sharp & Dohme LLC (Pharmaceutical company). Phase: Human Pharmacology (Phase I)- First administration to humans. Countries: Belgium (ongoing, recruiting).
Therapeutic area(s): Diseases [C] - Parasitic Diseases [C03]
Gender: Male. Age: 18-64 years. Enrolment: 16.
Status: Ongoing, recruiting. Start date (EU): 2026-07-31. Decision date: 2026-07-27. Results received: No. Last updated: 2026-07-27.

Condition(s): Malaria

Source: https://euclinicaltrials.eu/ctis-public/view/2026-526674-17-00